EU clinical trial 2026-525234-39-00: A Phase 1 Study of JNJ-95804306 for Relapsed or Refractory Hematological Malignancies
Protocol code: 95804306EDI1001
Sponsor: Janssen Cilag International (Pharmaceutical company). Phase: Human Pharmacology (Phase I)- First administration to humans. Countries: France (authorised, recruiting), Spain (authorised, recruiting), Germany (authorised, recruitment pending), Denmark (authorised, recruiting), Belgium (ongoing, recruiting).
Therapeutic area(s): Diseases [C] - Neoplasms [C04]
Gender: Female, Male. Age: 18-64 years, 65+ years. Enrolment: 175.
Start date (EU): 2026-07-13. Decision date: 2026-07-13. Results received: No. Last updated: 2026-07-16.
Decision dates by country: BE: 2026-07-13, DK: 2026-07-13, FR: 2026-07-15, DE: 2026-07-15, ES: 2026-07-16

Condition(s): Relapsed or Refractory acute myeloid leukemia, Relapsed or Refractory chronic lymphocytic leukemia, Relapsed or Refractory higher-risk myelodysplastic syndromes, Relapsed or Refractory small lymphocytic lymphoma

Source: https://euclinicaltrials.eu/ctis-public/view/2026-525234-39-00